EU clinical trial 2024-513746-11-00: Neovascular glaucoma prevention by intravitreal injections of anti-VEGF in patients treated by protontherapy in case of large choroid melanoma
Protocol code: 15-API-01
Sponsor: Centre Hospitalier Universitaire De Nice (Hospital/Clinic/Other health care facility). Phase: Therapeutic confirmatory (Phase III). Countries: France (ended).
Therapeutic area(s): Diseases [C] - Eye Diseases [C11]
Gender: Female, Male. Age: 18-64 years, 65+ years. Enrolment: 56.
Status: Ended. Start date (EU): 2017-06-08. End date (EU): 2025-01-31. Decision date: 2024-10-01. Results received: Yes. Last updated: 2024-12-19.

Condition(s): Patient with large choroid melanoma 7 mm thick and/or more than 15 mm of basal diameter treated by proton therapy
Product: Eylea 40 mg/mL solution for injection in pre-filled syringe

Primary endpoint: Occurrence of neovascular glaucoma after radiation-induced proton therapy. Clinical diagnosis (examination at the slit lamp)

Source: https://euclinicaltrials.eu/ctis-public/view/2024-513746-11-00